EU clinical trial 2023-506396-94-00: A first-in-human phase 1, single center, randomized, double-blind, placebo-controlled study to evaluate the safety and immunogenicity of three dose levels of the OVX033 vaccine, after intramuscular administration in healthy subjects aged 18-49 years
Protocol code: OVX033-001
Sponsor: Osivax (Pharmaceutical company). Phase: Human Pharmacology (Phase I)- First administration to humans. Countries: France (ended).
Therapeutic area(s): Diseases [C] - Virus Diseases [C02]
Gender: Female, Male. Age: 18-64 years. Enrolment: 48.
Status: Ended. Start date (EU): 2024-01-08. End date (EU): 2024-11-29. Decision date: 2023-11-30. Results received: No. Last updated: 2024-12-09.

Condition(s): Sarbecovirus diseases

Source: https://euclinicaltrials.eu/ctis-public/view/2023-506396-94-00